EU clinical trial 2024-514759-13-01: [18F]Fluoride PET-CT in psoriasis patients at risk for developing psoriatic arthritis
Sponsor: Stichting Amsterdam UMC (Hospital/Clinic/Other health care facility). Phase: Therapeutic exploratory (Phase II). Countries: Netherlands (ongoing, recruiting).
Therapeutic area(s): Diseases [C] - Skin and Connective Tissue Diseases [C17]; Diseases [C] - Musculoskeletal Diseases [C05]
Gender: Female, Male. Age: 18-64 years, 65+ years. Enrolment: 15.
Status: Ongoing, recruiting. Start date (EU): 2024-12-16. Decision date: 2024-12-16. Results received: No. Last updated: 2024-12-16.

Condition(s): Psoriasis
Product: Sodium Fluoride (18F) Life Radiopharma 0,1 - 4 GBq/ml solution injectable

Primary endpoint: The number of individuals with PET-positive lesions and the distribution of PET-positive lesions.
Endpoint(s): The correlation between PET outcome and development of PsA in 2 years follow-up, The quantitative [18F]Fluoride uptake in PET-positive lesions

Source: https://euclinicaltrials.eu/ctis-public/view/2024-514759-13-01